EU clinical trial 2024-511753-22-00: ASSURE: An Open Label Long-Term Study to Evaluate the Safety and Tolerability of Seladelpar in Subjects with Primary Biliary Cholangitis (PBC)
Protocol code: CB8025-31731-RE
Sponsor: Gilead Sciences Inc. (Pharmaceutical company). Phase: Therapeutic confirmatory (Phase III). Countries: Czechia (ongoing, recruitment ended), Belgium (ongoing, recruitment ended), Spain (ongoing, recruitment ended), Hungary (ongoing, recruitment ended), Italy (ongoing, recruitment ended), Netherlands (ongoing, recruitment ended), Romania (ongoing, recruitment ended), Germany (ongoing, recruitment ended), France (ongoing, recruitment ended), Greece (ongoing, recruitment ended), Austria (ongoing, recruitment ended), Poland (ongoing, recruitment ended).
Therapeutic area(s): Phenomena and Processes [G] - Immune system processes [G12]
Gender: Female, Male. Age: 18-64 years, 65+ years. Enrolment: 67.
Status: Ongoing, recruitment ended. Start date (EU): 2021-05-26. Decision date: 2024-07-11. Results received: No. Last updated: 2026-01-30.
Decision dates by country: NL: 2024-07-11, HU: 2024-07-15, AT: 2024-07-16, PL: 2024-07-15, ES: 2024-07-15, BE: 2024-07-11, FR: 2024-07-16, GR: 2024-07-29, CZ: 2024-07-15, IT: 2024-07-16, RO: 2024-07-16, DE: 2024-07-15

Condition(s): Primary Biliary Cholangitis

Primary endpoint: Treatment-emergent AEs (National Cancer Institute [NCI] Common Terminology Criteria for Adverse Events [CTCAE] Version 5.0), biochemistry and hematology results are collected
Endpoint(s): Occurrence of the following adjudicated PBC clinical outcomes: -Overall death -Liver transplantation -MELD score ≥ 15 for at least 2 consecutive visits -Ascites requiring treatment -Hospitalization for new onset or recurrence, of any: -Variceal bleeding, Hepatic encephalopathy, Spontaneous bacterial peritonitis, Biochemical markers: -Response on composite of ALP and total bilirubin -Proportion of subjects with normalization of ALP -Relative and absolute changes of the following: -Alkaline phosphatase (ALP) -Aspartate aminotransferase (AST) -Alanine aminotransferase (ALT) -Gamma-glutamyl transferase (GGT) -Bilirubin (total, direct, indirect), Change from Baseline in pruritus NRS

Source: https://euclinicaltrials.eu/ctis-public/view/2024-511753-22-00